EU clinical trial 2025-521779-30-00: A Phase 2, Randomized, Masked, Placebo-Controlled Study of Subcutaneously Administered ADX-038 in Participants With Geographic Atrophy (GA) Secondary to Age-Related Macular Degeneration (AMD)
Protocol code: ADX-038-202
Sponsor: Adarx Pharmaceuticals Inc. (Pharmaceutical company). Phase: Therapeutic exploratory (Phase II). Countries: Germany (authorised, recruitment pending), Portugal (authorised, recruitment pending), Italy (authorised, recruitment pending), Spain (authorised, recruitment pending).
Therapeutic area(s): Diseases [C] - Eye Diseases [C11]
Gender: Female, Male. Age: 18-64 years, 65+ years. Enrolment: 76.
Status: Authorised, recruitment pending. Decision date: 2026-03-17. Results received: No. Last updated: 2026-03-27.
Decision dates by country: DE: 2026-03-18, IT: 2026-03-27, PT: 2026-03-17, ES: 2026-03-26

Condition(s): Geographic atrophy secondary to age-related macular degeneration
Product: ADX-038, Sodio cloruro Galenica Senese 0,9% solvente per uso parenterale

Primary endpoint: Slope of change in GA area (square root transformation) as measured by FAF from baseline to Month 12 (expressed in mm/year) in the study eye
Endpoint(s): Slope of change in GA area (square root transformation) as measured by FAF from baseline to Month 24 (expressed in mm/year) in the study eye; Rate of change in the macular area of photoreceptor loss (defined as an EZ-RPE thickness of 0 μm) assessed by OCT and EZ mapping at Month 12 and Month 24, Proportion of participants with ≥15 letter loss in ETDRS letters in the study eye at 2 consecutive visits or EOS Visit

Source: https://euclinicaltrials.eu/ctis-public/view/2025-521779-30-00